EU clinical trial 2024-512451-20-00: A multicenter, randomized, double-blind, placebo-controlled TRial evaluating Immunosuppressive treatment in patients with chronic virus-Negative Inflammatory cardiomyopaThY (TRINITY trial)
Protocol code: TRINITY
Sponsor: Klinikum der Universitaet Muenchen AöR (Hospital/Clinic/Other health care facility). Phase: Phase II and Phase III (Integrated). Countries: Germany (ended).
Therapeutic area(s): Diseases [C] - Cardiovascular Diseases [C14]
Gender: Female, Male. Age: 18-64 years, 65+ years. Enrolment: 130.
Status: Ended. Start date (EU): 2023-02-28. End date (EU): 2025-04-14. Decision date: 2024-10-14. Results received: Yes. Last updated: 2024-10-14.

Condition(s): Patients with biopsy-proven virus-negative inflammatory dilated or nondilated left ventricular cardiomyopathy and persistent deterioration of cardiac function despite optimal medical treatment (OMT) for heart failure
Product: The prednisolone tablets are over-encapsulated for use in this clinical trial. Prednisolone capsules and placebo capsules are identical in appearance., The manufacturer of the product Mowel (mycophenolatmofetil) produces placebo tablets containing the same ingredients except mycophenolatmofetil. Mowel tablets and placebo tablets are identical in appearance., Prednisolon 1 mg JENAPHARM, Mowel 500 mg Filmtabletten, Prednisolon 10 mg GALEN® Tabletten, Prednisolon 20 mg GALEN® Tabletten, Prednisolon 5 mg JENAPHARM

Primary endpoint: Two co-primary endpoints (hierarchical testing): 1. Absolute increase in LVEF at 12 months follow-up as assessed by blinded investigators of the MRI core lab (metric endpoint) 2. Proportion of patients with an absolute increase in LVEF ≥10% at 12 months follow-up as assessed by blinded investigators of the MRI core lab (binary endpoint).
Endpoint(s): Composite clinical outcome: cardiac death, heart transplantation, LVAD implantation or a heart failure event (hospitalization for heart failure or the equivalent, i.e. an urgent HF visit) within 12 months from randomization, analyzed as time to first event., Absolute increase in LVEF and rate of increase by ≥10% at 6 months follow-up (MRI, metric, and binary endpoint)., Absolute decrease of left ventricular diameters, volumes, mass and sphericity from baseline to 6 and 12 months follow-up (MRI)., Changes in global longitudinal strain from baseline to 6 and 12 months follow-up (MRI)., Absolute increase in LVEF and rate of increase by ≥10% at 6 and 12 months follow-up (echo, metric and binary)., Decrease of left ventricular diameters and volumes by ≥10% at 6 and 12 months follow-up (echo)., Changes in global longitudinal (LV), free wall (RV) and left atrial strain (LA) from baseline to 6 and 12 months follow-up (echo)., Changes in diastolic parameters from baseline to 6 and 12 months follow-up (echo)., Presence of MR/TR >2 at baseline and at 6 and 12 months follow-up (echo)., Changes in cardiopulmonary exercise capacity: Distance in the sixminute walk test (6MWT) from baseline to 6 and 12 months follow-up and (optionally) VO2max, anaerobic threshold and VE/VCO2 on spiroergometry., Changes in NYHA functional class from baseline to 6 and 12 months follow-up., Changes in patient-reported outcome (quality of life; QOL) from baseline to follow-up as assessed by the Kansas City Cardiomyopathy Questionnaire (KCCQ)., Changes in cardiac autonomic function (PRD, DC) from baseline to 6 and 12 months follow-up., Time to the first occurrence of any of the components of the composite safety outcome: death of any cause, arrhythmias requiring intervention, severe adverse events requiring hospitalization., Time-averaged proportional change in NT-proBNP.

Source: https://euclinicaltrials.eu/ctis-public/view/2024-512451-20-00